EU clinical trial 2022-501535-16-00: A Phase 3, Open-label, 52-week Study to Assess the Safety, Tolerability, and Efficacy of Rocatinlimab (AMG 451) in Adolescent Subjects Aged ≥ 12 to < 18 years With Moderate-to-severe Atopic Dermatitis (AD) (ROCKET-Orbit)
Protocol code: 20210263
Sponsor: Amgen Inc. (Pharmaceutical company). Phase: Therapeutic confirmatory (Phase III). Countries: Portugal (not authorised), Hungary (not authorised), Denmark (not authorised), Germany (not authorised), Italy (not authorised), Austria (not authorised), Finland (not authorised), Spain (not authorised), Poland (not authorised).
Therapeutic area(s): Diseases [C] - Immune System Diseases [C20]
Gender: Female, Male. Age: 0-17 years. Enrolment: 58.
Status: Not authorised. Decision date: 2023-03-21. Results received: No. Last updated: 2023-03-27.
Decision dates by country: AT: 2023-03-27, DK: 2023-03-21, FI: 2023-03-27, DE: 2023-03-21, HU: 2023-03-23, IT: 2023-03-22, PT: 2023-03-23, ES: 2023-03-21, PL: 2023-03-27

Condition(s): Atopic Dermatitis (AD)

Primary endpoint: Treatment-emergent serious adverse events

Source: https://euclinicaltrials.eu/ctis-public/view/2022-501535-16-00